EU clinical trial 2024-511454-45-00: PHASE 1/2 FIH STUDY OF REGN5458 (ANTI-BCMA X ANTI-CD3 BISPECIFIC ANTIBODY) IN PATIENTS WITH RELAPSED OR REFRACTORY MULTIPLE MYELOMA
Protocol code: R5458-ONC-1826
Sponsor: Regeneron Pharmaceuticals Inc. (Pharmaceutical company). Phase: Phase I and Phase II (Integrated)- First administration to humans. Countries: Belgium (ongoing, recruiting), Spain (ongoing, recruiting).
Therapeutic area(s): Diseases [C] - Neoplasms [C04]
Gender: Female, Male. Age: 18-64 years, 65+ years. Enrolment: 16.
Status: Ongoing, recruiting. Start date (EU): 2020-11-09. Decision date: 2024-08-23. Results received: No. Last updated: 2026-07-22.
Decision dates by country: ES: 2024-08-23, BE: 2024-08-26

Condition(s): Relapsed or Refractory Multiple Myeloma
Product: Dexamethasone phosphate 4 mg/ml solution for injection/infusion, RoActemra 20 mg/mL concentrate for solution for infusion, Dexamethasone 4 mg tablets, Diluent for REGN5458, Diphenhydramine Hydrochloride 25 mg Tablets, Dermodrin 30 mg/2 ml soluție injectabilă, Linvoseltamab, Paracetamol 500 mg Film-Coated Tablets, Linvoseltamab

Primary endpoint: Phase 1: Incidence of dose-limiting toxicities (DLTs) from the first dose through the end of the DLT observation period, Phase 1: Incidence and severity of treatment-emergent adverse events (TEAEs), Phase 1: Incidence and severity of adverse events of special interest (AESI), Phase 1, Part 2: Assessment of the pharmacokinetics (PK) of linvoseltamab, Phase 2, cohorts 1 and 2: Objective response rate (ORR) as determined by an Independent Review Committee (IRC), Phase 2, cohort 3: Incidence and severity of cytokine release syndrome (CRS) with linvoseltamab, Phase 2, cohort 3: ORR of IV linvoseltamab as assessed by investigator
Endpoint(s): Phase 1 part 1 and Phase 2: Concentrations of linvoseltamab in the serum over time, Phase 1 and Phase 2: Incidence over time of anti-drug antibodies (ADAs) to linvoseltamab, Phase 1 and Phase 2: Titer of anti-drug antibodies (ADAs) to linvoseltamab over time, Phase 1 and Phase 2: Incidence of neutralizing antibodies (Nab) to linvoseltamab over time, Phase 2, cohorts 1 and 2: Duration of response (DOR) as determined by an IRC, measured using the IMWG criteria, Phase 1 and Phase 2: DOR as determined by an investigator, measured using the International Myeloma Working Group (IMWG) criteria, Phase 2: Progression-free survival (PFS) as determined by an IRC, measured using the IMWG criteria, Phase 1 and Phase 2: PFS as determined by an investigator, measured using the IMWG criteria, Phase 1: Rate of minimal residual disease (MRD) negative status, as determined by the investigator using the IMWG criteria, Phase 2: Rate of MRD negative status, Phase 1 and Phase 2: Overall survival (OS), Phase 1, part 1 dose level 7 (DL7): ORR as measured as determined by blinded IRC, as measured using the IMWG criteria, Phase 1 and Phase 2: ORR as determined by the investigator, measured using the IMWG criteria, Phase 2: Effects of linvoseltamab on health-related quality of life (HRQoL) and patient-reported symptoms and functioning per European Organization for Research and Treatment of Cancer Quality of Life Questionnaire (EORTC QLQ-C30), Phase 2: Effects of linvoseltamab on HRQOL and patient-reported symptoms and functioning per Quality of Life Questionnaire-Multiple Myeloma module 20 [QLQ-MY20]), Phase 2: Effects of linvoseltamab on HRQOL and patient-reported symptoms and functioning per EuroQoL-5 Dimension-3 Level Scale [EQ-5D-3L]), Phase 2: Change in patient-reported global health status/QoL per EORTC QLQ-C30, Phase 2: Time to definitive deterioration in patient-reported global health status/QoL per EORTC QLQ-C30, Phase 2: Effects of linvoseltamab on patient-reported functions and symptoms per EORTC QLQ-C30, Phase 2: Effects of linvoseltamab on patient-reported functions and symptoms per QLQ-MY20, Phase 2: Incidence and severity of TEAEs with linvoseltamab, Phase 2: Incidence and severity of AESIs with linvoseltamab

Source: https://euclinicaltrials.eu/ctis-public/view/2024-511454-45-00